EU clinical trial 2024-512505-66-00: An Operationally Seamless Phase 2/3, Randomized, Active Controlled Study Evaluating the Safety and Efficacy of an Oral Weekly Regimen of GS-1720 in Combination with GS-4182 Versus Biktarvy in Treatment Naive People with HIV-1
Protocol code: GS-US-695-7156
Sponsor: Gilead Sciences Inc. (Pharmaceutical company). Phase: Phase II and Phase III (Integrated). Countries: Romania (ended), Spain (ended), Poland (ended), Germany (ended), Portugal (ended).
Therapeutic area(s): Diseases [C] - Virus Diseases [C02]
Gender: Female, Male. Age: 18-64 years, 65+ years. Enrolment: 186.
Status: Ended. Start date (EU): 2025-03-03. End date (EU): 2025-08-20. End date: 2026-03-16. Decision date: 2025-02-12. Results received: No. Last updated: 2025-10-29.
Decision dates by country: ES: 2025-02-12, RO: 2025-02-24, DE: 2025-04-01, PT: 2025-02-18, PL: 2025-02-24

Condition(s): HIV-1 Infection
Product: GS-4182, Biktarvy 50 mg/200 mg/25 mg film-coated tablets, GS-1720

Primary endpoint: Phase 2: The proportion of participants with HIV-1 RNA < 50 copies/mL at Week 24 as determined by the United States (US) Food and Drug Administration (FDA)-defined snapshot algorithm, Phase 3: The proportion of participants with HIV-1 RNA < 50 copies/mL at Week 48 as determined by the US FDA-defined snapshot algorithm
Endpoint(s): The proportion of participants with HIV-1 RNA < 50 copies/mL at Weeks 12 and 48 as determined by the US FDA-defined snapshot algorithm, The change from baseline in log10 HIV-1 RNA and CD4 cell count at Weeks 12, 24, and 48, The proportion of participants experiencing treatment-emergent adverse events (TEAEs), and treatment-emergent laboratory abnormalities through Weeks 12, 24, and 48, PK parameters (Cmax, Tmax, Ctau, and AUCtau, as applicable) of GS-1720 and lenacapavir (LEN), Phase 3:The proportion of participants with HIV-1 RNA < 50 copies/mL at Week 96 as determined by the US FDA-defined snapshot algorithm, The change from baseline in log10 HIV-1 RNA and CD4 cell count at Weeks 48 and 96, The proportion of participants experiencing TEAEs, and treatment-emergent laboratory abnormalities through Weeks 48 and 96

Source: https://euclinicaltrials.eu/ctis-public/view/2024-512505-66-00